EU clinical trial 2022-500385-99-00: European DisCoVeRy for Solidarity: An Adaptive Pandemic and Emerging Infection Platform Trial (SolidAct)
Sponsor: Oslo University Hospital Hf (Hospital/Clinic/Other health care facility). Phase: Therapeutic confirmatory (Phase III). Countries: Norway (ended), Portugal (ended), France (ended), Greece (ended), Luxembourg (ended), Hungary (ended), Slovakia (ended), Italy (ended), Czechia (ended), Ireland (ended), Austria (ended), Spain (ended), Germany (ended), Belgium (ended).
Therapeutic area(s): Diseases [C] - Virus Diseases [C02]
Gender: Female, Male. Age: 18-64 years, 65+ years. Enrolment: 2000.
Status: Ended. Start date (EU): 2021-06-03. End date (EU): 2023-01-23. Decision date: 2022-04-27. Results received: Yes. Last updated: 2023-01-30.
Decision dates by country: IE: 2022-05-05, HU: 2022-05-02, LU: 2022-05-10, AT: 2022-05-25, CZ: 2022-05-05, SK: 2022-04-28, NO: 2022-04-27, DE: 2022-05-02, FR: 2022-04-27, BE: 2022-05-02, IT: 2022-05-02, GR: 2022-04-27, PT: 2022-04-27, ES: 2022-04-28

Condition(s): SARS-CoV II infection (Coronavirus disease)
Product: Olumiant 2 mg film-coated tablets, Placebo to match film-coated baricitinib 2mg tablets

Primary endpoint: Master Protocol: Part A, moderate disease: Occurrence of disease progression, defined as a progression of disease state from moderate (WHO score 4-5) to severe/critical (WHO score 6-9) or death (WHO score 10) within 14 days., Master Protocol: Part B, severe disease: Occurrence of death within 60 days., Baricitinib Protocol: Occurrence of death within 60 days.
Endpoint(s): Master Protocol: 1.1 Occurrence of disease progression, defined as a progression of disease state from moderate (WHO score 4-5) to severe/critical/death (WHO score 6-10) or from severe/critical (WHO score 6-9) to death within 28 days., Master Protocol: 1.2 Time from randomization to sustained recovery, defined as being discharged from the index hospitalization, followed by being alive and at home for 14 consecutive days within 90 days., Master Protocol: 1.3 Time from randomization to first hospital discharge within 90 days., Master Protocol: 1.4 Disease state on a 5-point scale defined as 1. Mild (WHO score 1-3) or better, 2. Moderate (WHO score 4-5), 3. Severe (WHO score 6), 4. Critical (WHO score 7-9) or 5. Death at Day 15 and 29., Master Protocol: 1.5 Time from randomization to recovery defined as no need for oxygen., Master Protocol: 1.6 SpO2/FiO2-ratio at day 3, 5 and 8., Master Protocol: 2. Viral clearance as assessed by SARS-CoV-2 PCR in oropharyngeal specimens during hospitalization., Master Protocol: 3. Biochemical parameters including inflammatory markers (C-reactive protein, ferritin, lactate dehydrogenase, procalcitonin, D-dimer, leukocyte subsets and cytokine panels) during hospitalisation., Master Protocol: 4. Occurence of serious adverse events leading to study treatment discontinuation or death., Master Protocol: 5. The Oslo COVID-19 QLQ-PW80 subscale scores at Day 91., Baricitinib Protocol: 1. Occurrence of disease progression, defined as a progression from severe (WHO score 6) to critical/death (WHO score 7-10) or from critical (WHO score 7-9) to death within 28 days., Baricitinib Protocol: 2. Time from randomization to sustained recovery, with sustained recovery defined as being discharged from the index hospitalization, followed by being alive and home for 14 consecutive days within 90 days, Baricitinib Protocol 3. Time from randomization to first hospital discharge within 90 days., Baricitinib Protocol: 4. Disease state on a 5 point scale defined as 1. Mild (WHO score 1-3) or better, 2. Moderate (WHO score 4-5), 3. Severe (WHO score 6), 4. Critical (WHO score 7-9) or 5. Death at Day 15 and 29., Baricitinib Protocol: 5. Occurrence of serious adverse events leading to study treatment discontinuation or death., Baricitinib Protocol: 6. Viral clearance as assessed by SARS-CoV-2 PCR in oropharyngeal specimens during hospitalization., Baricitinib Protocol: 7. Inflammatory markers (C-reactive protein, ferritin, lactate dehydrogenase, procalcitonin, Ddimer, leukocyte subsets and cytokine panels) during hospitalisation.

Source: https://euclinicaltrials.eu/ctis-public/view/2022-500385-99-00